EU clinical trial 2023-507633-21-01: An Open-Label, Multicenter Extension Study Evaluating the Patient Perspective of the Physical Impact of Multiple Sclerosis and Providing Continued Access to Ocrelizumab in Patients with Multiple Sclerosis Previously Enrolled in a Genentech and/or F. Hoffmann-La Roche Ltd Sponsored Study and without Access to A Post Trial Access Program
Protocol code: MN45053
Sponsor: F. Hoffmann-La Roche AG (Pharmaceutical company). Phase: Therapeutic confirmatory (Phase III). Countries: France (ongoing, recruiting), Germany (ongoing, recruiting), Bulgaria (authorised, recruiting).
Therapeutic area(s): Diseases [C] - Nervous System Diseases [C10]
Gender: Female, Male. Age: 18-64 years, 65+ years. Enrolment: 136.
Start date (EU): 2024-12-09. Decision date: 2024-11-22. Results received: No. Last updated: 2026-07-06.
Decision dates by country: FR: 2024-11-22, BG: 2025-11-28, DE: 2024-12-04

Condition(s): Multiple Sclerosis
Product: Ocrevus 300 mg concentrate for solution for infusion, Ocrevus 920 mg solution for injection

Primary endpoint: 1. Change from baseline to end of study in Patient-Reported Outcome Measure Information System/Quality of Life in Neurological Disorders Physical Function Measure for Multiple Sclerosis 15a (PROMISnq PFMS-15a), 2. Number of eligible participants who have received access to ocrelizumab in the study (time frame: up to 5 years)
Endpoint(s): 1. The incidence, nature, severity and outcome of serious adverse events, adverse events leading to discontinuation, and adverse events of special interest

Source: https://euclinicaltrials.eu/ctis-public/view/2023-507633-21-01